EU clinical trial 2025-523616-36-00: Exploratory study evaluating the relevance of [68Ga]Ga-FAPI-46 for staging and identifying progressing patients with transthyretin cardiac amyloidosis
Protocol code: RC25_0276
Sponsor: Centre Hospitalier Universitaire De Nantes (Hospital/Clinic/Other health care facility). Phase: Therapeutic exploratory (Phase II). Countries: France (authorised, recruitment pending).
Therapeutic area(s): Analytical, Diagnostic and Therapeutic Techniques and Equipment [E] - Diagnosis [E01]; Diseases [C] - Cardiovascular Diseases [C14]
Gender: Female, Male. Age: 18-64 years, 65+ years. Enrolment: 40.
Status: Authorised, recruitment pending. Decision date: 2026-06-13. Results received: No. Last updated: 2026-06-13.

Condition(s): Transthyretin cardiac amyloidosis
Product: FAPI-46 (68Ga)

Primary endpoint: Comparison of quantitative evaluation of [68Ga]Ga-FAPI-46 cardiac uptake (SUV Ratio : left ventricular myocardial SUV to blood pool SUV) among the different Columbia ATTR-CM stages (1-3 points ; 4-6 points ; 7-9 points).
Endpoint(s): Tolerance of [68Ga]Ga-FAPI-46 cardiac PET will be assessed by clinical monitoring of the patient from the time of injection until approximately 60 or 90 minutes post-injection, depending on whether CT or MR imaging is performed. Clinical data will be collected prior and 5/10 min after [68Ga]Ga-FAPI-46 injection, prior to image acquisition and at the end of acquisition, Comparison of the qualitative (absence of uptake, focal uptake, diffuse uptake, focal or diffuse uptake on both left and right ventricule) and quantitative (left ventricular and right ventricular SUVmax, SUVmean and LV molecular volume) analysis of [68Ga]Ga-FAPI-46 cardiac PET imaging to both CMR and echocardiography parameters (extent of LV late gadolinium enhancement, extracellular volume, LV and RV longitudinal strain, LV myocardial mass, LV and RV ejection fractions), 3a) Assess potential of [68Ga]Ga-FAPI-46 in staging ATTR-CM severity through comparison of qualitative and quantitative evaluation of [68Ga]Ga-FAPI-46 cardiac uptake among the Columbia stages (1-3 points ; 4-6 points ; 7-9 points) and each of its components : i. NAC and Mayo ATTR-CM stages (stage I, stage II, stage III). ii. bio-clinical parameters (NT pro BNP, eGFR and Troponin T values, daily dose of furosemide or equivalent, and NYHA functional class), 3b) Assess potential of [68Ga]Ga-FAPI-46 in staging ATTR-CM severity through comparison of the combined qualitative and quantitative analysis of CMR and [68Ga]Ga-FAPI-46 cardiac PET imaging to Columbia stages (1-3 points ; 4-6 points ; 7-9 points) and each of its components, 3c) Assess potential of [68Ga]Ga-FAPI-46 in staging ATTR-CM severity through comparison of automated analysis of [68Ga]Ga-FAPI-46 cardiac PET combined or not with CMR to Columbia stages (1-3 points ; 4-6 points ; 7-9 points) and each of its components, 4a) Assess the potential of [68Ga]Ga-FAPI-46 to identify progressing ATTR-CM patients through comparison of qualitative and quantitative evaluation of [68Ga]Ga-FAPI-46 cardiac uptake among patients with and patients without criteria for disease progression according to the 2021 and/or 2026 ESC experts consensus criteria, and patients with and without Oral Diuretic Intensification (ODI), 4b) Assess the potential of [68Ga]Ga-FAPI-46 to identify progressing ATTR-CM patients through comparison of the combined qualitative and quantitative analysis of CMR and [68Ga]Ga-FAPI-46 cardiac PET imaging among patients with and patients without criteria for disease progression according to the 2021 and/or 2026 ESC experts consensus criteria, and patients with and without ODI, 4c) Assess the potential of [68Ga]Ga-FAPI-46 to identify progressing ATTR-CM patients through comparison of automated analysis of [68Ga]Ga-FAPI-46 cardiac PET combined or not with CMR among patients with and patients without criteria for disease progression according to the 2021 and/or 2026 ESC experts consensus criteria, and patients with and without ODI, Comparison of qualitative and quantitative evaluation of [68Ga]Ga-FAPI-46 cardiac uptake among patients with WT-ATTR CM and h-ATTR CM, Comparison of qualitative and quantitative evaluation of [68Ga]Ga-FAPI-46 cardiac uptake to Perugini score

Source: https://euclinicaltrials.eu/ctis-public/view/2025-523616-36-00